EU clinical trial 2023-508519-22-00: An open-label, single-dose, parallel-group study to evaluate the plasma pharmacokinetics of leniolisib in subjects with impaired hepatic function and in subjects with normal hepatic function
Protocol code: LE 6101
Sponsor: Pharming Technologies B.V. (Pharmaceutical company). Phase: Human Pharmacology (Phase I)- Other. Countries: Germany (ended), Hungary (ended).
Therapeutic area(s): Diseases [C] - Immune System Diseases [C20]
Gender: Female, Male. Age: 18-64 years, 65+ years. Enrolment: 48.
Status: Ended. Start date (EU): 2024-01-26. End date (EU): 2025-11-09. Decision date: 2024-01-10. Results received: No. Last updated: 2025-11-06.
Decision dates by country: DE: 2024-01-10, HU: 2025-03-10

Condition(s): Activated Phosphoinositide 3-Kinase Delta Syndrome

Source: https://euclinicaltrials.eu/ctis-public/view/2023-508519-22-00